EU clinical trial 2023-508139-29-00: An Open-Label, Multicenter, First-in-Human, Phase 1 Dose Escalation and Multicohort Expansion Study of INBRX-109 in Subjects with Locally Advanced or Metastatic Solid Tumors, Including Sarcomas.
Protocol code: Ph1 INBRX-109 Part 3
Sponsor: Inhibrx Biosciences Inc. (Pharmaceutical company). Phase: Phase I and Phase II (Integrated)- First administration to humans. Countries: France (ongoing, recruiting), Italy (ongoing, recruiting), Netherlands (ongoing, recruiting), Spain (ongoing, recruiting).
Therapeutic area(s): Diseases [C] - Neoplasms [C04]
Gender: Female, Male. Age: 0-17 years, 18-64 years, 65+ years. Enrolment: 37.
Status: Ongoing, recruiting. Start date (EU): 2024-06-26. Decision date: 2024-04-30. Results received: No. Last updated: 2026-02-19.
Decision dates by country: NL: 2024-04-30, IT: 2024-05-03, ES: 2024-05-03, FR: 2024-05-03

Condition(s): Advanced or metastatic solid tumors
Product: Campto 20 mg/ml Konzentrat zur Herstellung einer Infusionslösung, Campto 20 mg/ml Konzentrat zur Herstellung einer Infusionslösung, DEXAMETHASONE, Temodal 180 mg hard capsules, Temodal 5 mg hard capsules, Temodal 140 mg hard capsules, Temodal 100 mg hard capsules, Campto 20 mg/ml Konzentrat zur Herstellung einer Infusionslösung, Temodal 20 mg hard capsules, Temodal 250 mg hard capsules

Primary endpoint: 1. TEAEs including determination of DLTs and SAEs. AEs will be assessed, and severity assigned by using the NCI CTCAE v5.0., 2. Clinical response including ORR and DOR per RECIST v1.1 in colorectal adenocarcinoma and Ewing sarcoma.
Endpoint(s): 1. PK parameters: AUC0-inf, AUC0-last, AUC0-21d or AUC0-28d (depending on dosing interval), Cmax, Ctrough, and Tmax will be estimated using standard non compartmental analysis (NCA) as the data allow. Other PK parameters (λz, t½, Vd, CL, and accumulation ratios [RCmax, RCtrough]) will be calculated if data permit., 2. Incidence, quantity, and effect of ADAs against INBRX-109., 3. Median PFS (colorectal adenocarcinoma and Ewing sarcoma).

Source: https://euclinicaltrials.eu/ctis-public/view/2023-508139-29-00